EU clinical trial 2022-500765-27-00: An Open-Label, Multicenter, Extension Study to Provide Continued Treatment for Patients with Hematologic Malignancies Previously Enrolled in Studies with Tafasitamab.
Protocol code: MOR208C216
Sponsor: Incyte Corp. (Pharmaceutical company). Phase: Therapeutic confirmatory (Phase III). Countries: Italy (ongoing, recruiting), Spain (ongoing, recruiting), Hungary (ongoing, recruiting).
Therapeutic area(s): Diseases [C] - Neoplasms [C04]
Gender: Female, Male. Age: 18-64 years, 65+ years. Enrolment: 5.
Status: Ongoing, recruiting. Start date (EU): 2022-11-03. Decision date: 2022-10-07. Results received: No. Last updated: 2026-06-18.
Decision dates by country: HU: 2024-04-29, IT: 2022-10-07, ES: 2022-10-11

Condition(s): Hematologic malignancies
Product: MINJUVI 200 mg powder for concentrate for solution for infusion

Primary endpoint: Incidence and severity of SAEs, AESIs and selective AEs in patients receiving tafasitamab

Source: https://euclinicaltrials.eu/ctis-public/view/2022-500765-27-00